EU clinical trial 2024-514006-31-00: An open-label, multi-center, phase I/II study to assess safety, disease progression, and cellular kinetics following YTB323 administration in participants with non-active Progressive Multiple Sclerosis (PMS)
Protocol code: CYTB323R12101
Sponsor: Novartis Pharma AG (Pharmaceutical company). Phase: Phase I and Phase II (Integrated)- Other. Countries: Spain (authorised, recruitment pending), France (ongoing, recruiting), Italy (authorised, recruitment pending), Germany (authorised, recruitment pending).
Therapeutic area(s): Diseases [C] - Nervous System Diseases [C10]
Gender: Female, Male. Age: 18-64 years. Enrolment: 18.
Start date (EU): 2026-04-16. Decision date: 2025-04-22. Results received: No. Last updated: 2026-06-10.
Decision dates by country: DE: 2025-04-24, FR: 2025-04-22, IT: 2025-04-23, ES: 2025-04-24

Condition(s): Non-active Progressive Multiple Sclerosis (PMS)
Product: YTB323, CYCLOPHOSPHAMIDE, FLUDARABINE PHOSPHATE, TOCILIZUMAB

Primary endpoint: Occurrence, severity and frequency of dose limiting toxicities (DLTs), Adverse Events (AEs) and change from baseline over 2 years in safety parameters including, but not limited to vital signs, laboratory, ECG, neurological status, and safety measures from brain and spinal cord MRIs.
Endpoint(s): Change from baseline for clinical measures of disability (includes EDSS, T25FW, 9HPT, SDMT)., YTB323 transgene expression levels by qPCR over time in blood; cellular kinetics parameters (Cmax, AUC, Tmax, Clast, Tlast)., Safety data from each dose level., Pre-existing and treatment-induced immunogenicity (humoral, anti-YTB323 antibody; and cellular, presence of CAR19 specific CD4 and CD8 T cells measuring interferon gamma production).

Source: https://euclinicaltrials.eu/ctis-public/view/2024-514006-31-00